EU clinical trial 2025-520656-29-00: A study in healthy people to test whether BI 3000202 affects how 2 other medicines (rosuvastatin and digoxin) are taken up in the body
Protocol code: 1509-0014
Sponsor: Boehringer Ingelheim International GmbH (Pharmaceutical company). Phase: Human Pharmacology (Phase I)- Other. Countries: Germany (ended).
Therapeutic area(s): Not possible to specify
Gender: Female, Male. Age: 18-64 years. Enrolment: 14.
Status: Ended. Start date (EU): 2025-11-03. End date (EU): 2025-12-18. Decision date: 2025-09-11. Results received: No. Last updated: 2025-09-11.

Condition(s): Healthy volunteer trial

Source: https://euclinicaltrials.eu/ctis-public/view/2025-520656-29-00